EU clinical trial 2023-506333-29-00: A phase 3B exploratory multicenter open-label study to evaluate the effect of bimekizumab on gene expression biomarkers in study participants with moderate to severe plaque psoriasis.
Protocol code: PS0039
Sponsor: UCB Biopharma (Pharmaceutical company). Phase: Phase III and phase IV (Integrated). Countries: Poland (ongoing, recruitment ended), Germany (ongoing, recruitment ended).
Therapeutic area(s): Diseases [C] - Immune System Diseases [C20]
Gender: Female, Male. Age: 18-64 years, 65+ years. Enrolment: 46.
Status: Ongoing, recruitment ended. Start date (EU): 2024-10-01. Decision date: 2024-08-15. Results received: No. Last updated: 2026-05-27.
Decision dates by country: DE: 2024-08-15, PL: 2024-08-26

Condition(s): Moderate to Severe Plaque Psoriasis, Psoriatic arthritis
Product: bimekizumab

Primary endpoint: Composite gene expression score using reverse transcription-polymerase chain reaction (RT-PCR) in lesional skin at Baseline and Week 48 using preselected genes based on Bimekizumab mechanism of action and PSO disease biology pathways
Endpoint(s): 1. Treatment-emergent adverse events (TEAEs) from Baseline to the end of the Safety Follow-Up (SFU) 2. Treatment-emergent serious adverse event (TESAEs) from Baseline to the end of the SFU 3. TEAEs leading to permanent discontinuation of IMP from Baseline to the end of the SFU

Source: https://euclinicaltrials.eu/ctis-public/view/2023-506333-29-00